EU clinical trial 2022-501428-45-00: The DEXA-PSYCH Study: Dexamethasone Repurposing for Moderate to Severe Depression - A Double-Blind, Randomized, Parallel-Group, Placebo-Controlled Trial
Sponsor: Region Hovedstadens Psykiatriske (Hospital/Clinic/Other health care facility). Phase: Therapeutic confirmatory (Phase III). Countries: Denmark (ongoing, recruiting).
Therapeutic area(s): Psychiatry and Psychology [F] - Mental Disorders [F03]
Gender: Female, Male. Age: 18-64 years. Enrolment: 300.
Status: Ongoing, recruiting. Start date (EU): 2022-12-28. Decision date: 2022-10-12. Results received: No. Last updated: 2026-04-16.

Condition(s): Depression
Product: VENLAFAXINE, CITALOPRAM, QUETIAPINE, DEXAMETHASONE, NORTRIPTYLINE, Placebo pills containing lactose monohydrate, starch, gelatine, talc and magnesium stearate in a gelatin encapsulation., SERTRALINE, ESCITALOPRAM, MIRTAZAPINE, LITHIUM

Primary endpoint: Change from baseline (day 0) on the Montgomery-Asberg Depression Rating Scale (MADRS-10) at day 7.
Endpoint(s): Number of participants with remission (MADRS10 score less than or equal to 10) on day 7, Change in quality of life as measured by change from baseline (day 0) on the EQ-5D-5L on day 7., Safety outcomes (ARs (including SARs) occurring on or before day 10, all-cause discontinuation, vital signs, suicidal ideation (C-SSRS, day 7), laboratory tests, ECG, toxicity (GTI, day 7), side-effects of antidepressant (UKU-SSRI, day 7), positive psychotic symptoms (SAPS, day 7), manic symptoms (YMRS, day 7), admission (somatic and psychiatric, day 28), suicide attempts and completed suicides (day 28), all-cause mortality (day 28), Change from baseline (day 0) on the MADRS10 at day 4, 14 and 28., Change from baseline (day 0) on the Hamilton Depression Rating Scale (HAM-D17) on day 7 and 28., Change in quality of life as measured by change from baseline (day 0) on the EQ-5D-5L on day 28 and at 6-months follow up., Change in suicidal ideation as measured by change from baseline (day 0) on the Columbia-Suicide Severity Rating Scale (C-SSRS) on day 28 and at 6-months follow up., Number of participants with remission (MADRS10 score less than or equal to 10) at 6-month follow up., Relative risk of being unemployed or on full time sick leave at day 7, day 28 and at 6-months follow-up (as assessed through patient interviews) as well as beyond (as assessed through national Danish registers)., Relative risk of admissions due to psychiatric illness before 6-months follow-up (as assessed through patient interview and electronic health records) as well as beyond (as assessed through national Danish registers)., Relative risk of suicide attempts before 6-months follow-up (as assessed through patient interview and electronic health records) as well as beyond (as assessed through national Danish registers)., All-cause mortality at 6-months follow-up (as assessed through electronic health records) as well as beyond (as assessed through national Danish registers)., Change in anxiety symptoms as measured by change from baseline (day 0) on the Hamilton Anxiety Rating Scale (HAM-A) on day 7, 28 and at 6 months follow-up., Change in functioning as measured by change from baseline (day 0) on the Global Assessment of Functioning (GAF) scale on day 7, 28 and at 6 months follow-up., Change from baseline (day 0) on MDI on day 7 and 28 and at 6-months follow-up., Baseline levels of CRP and leucocytes in responders and non-responders as well as other biochemical markers assayed in biological samples., General level of physical and social activity as measured in the Monsenso app day 1- 28, Change in fatigue as measured by change from baseline (day 0) on the Functional Assessment of Chronic Illness Therapy-Fatigue (FACIT-F) scale on day 7, 28 and at 6 months follow up., Number of participants with response (MADRS10 score <50 % of the score at day 0) on day 7, Change from baseline (day 0) on the MADRS10 at 6-months follow up., 8. Change from baseline (day 0) on the MADRS6 (at day 4, 7, 14, 28 and at 6-months follow up) and HAM-D6 (at day 7, 28 and at 6-months follow up)., Self-rated MADRS scores on day 1-28 based on data collection in the Monsenso app., Sustained response. Number of participants with response (MADRS10 score <50 % of the score at day 0) both on day 7 and subsequently also on days 14 and 28.

Source: https://euclinicaltrials.eu/ctis-public/view/2022-501428-45-00